EU clinical trial 2023-505434-98-00: A Study to Assess the Pharmacokinetics of Rifaximin Soluble Solid Dispersion (SSD) Formulation in Adult Subjects with Impaired Hepatic Function
Protocol code: RNPK1018
Sponsor: Salix Pharmaceuticals Inc. (Pharmaceutical company). Phase: Human Pharmacology (Phase I)- Other. Countries: Hungary (ended).
Therapeutic area(s): Not possible to specify
Gender: Female, Male. Age: 18-64 years, 65+ years. Enrolment: 18.
Status: Ended. Start date (EU): 2023-11-13. End date (EU): 2024-05-24. End date: 2024-05-25. Decision date: 2023-10-13. Results received: No. Last updated: 2024-04-17.

Condition(s): Hepatic impairment.

Source: https://euclinicaltrials.eu/ctis-public/view/2023-505434-98-00